EU clinical trial 2023-506922-35-00: A Study of TAS2940 in Participants With Locally Advanced or Metastatic Solid Tumor Cancer
Protocol code: TAS2940-101
Sponsor: Taiho Oncology Inc. (Pharmaceutical company). Phase: Human Pharmacology (Phase I)- First administration to humans. Countries: France (ended).
Therapeutic area(s): Diseases [C] - Neoplasms [C04]
Gender: Female, Male. Age: 18-64 years, 65+ years. Enrolment: 23.
Status: Ended. Start date (EU): 2022-01-24. End date (EU): 2025-03-24. End date: 2025-03-25. Decision date: 2023-10-18. Results received: No. Last updated: 2024-12-04.

Condition(s): Locally Advanced or Metastatic Solid Tumors with EGFR and/or HER2 Aberrations

Source: https://euclinicaltrials.eu/ctis-public/view/2023-506922-35-00